EU clinical trial 2023-507563-19-00: A randomized, controlled, safety and tolerability study of VRDN-001, a humanized monoclonal antibody directed against the IGF-1 receptor, in participants with thyroid eye disease (TED)
Protocol code: VRDN-001-303
Sponsor: Viridian Therapeutics Inc. (Pharmaceutical company). Phase: Therapeutic confirmatory (Phase III). Countries: Germany (ended), Netherlands (ended), Poland (ended), France (ended), Spain (ended).
Therapeutic area(s): Diseases [C] - Eye Diseases [C11]; Diseases [C] - Immune System Diseases [C20]
Gender: Female, Male. Age: 18-64 years, 65+ years. Enrolment: 155.
Status: Ended. Start date (EU): 2024-11-05. End date (EU): 2026-01-19. End date: 2026-01-20. Decision date: 2024-10-28. Results received: No. Last updated: 2025-12-02.
Decision dates by country: NL: 2024-10-29, FR: 2025-01-13, DE: 2024-11-01, ES: 2025-01-13, PL: 2024-10-31

Condition(s): Thyroid eye disease
Product: VRDN-001 (Insulin-like growth factor-1 receptor [IGF-1R] inhibitor)

Primary endpoint: Treatment Emergent Adverse Event (TEAE) incidence rate through Week 15
Endpoint(s): Change from baseline in proptosis in the study eye as measured by exophthalmometer at Week 15, Treatment Emergent Adverse Event (TEAE) incidence rate through Week 52

Source: https://euclinicaltrials.eu/ctis-public/view/2023-507563-19-00